EU clinical trial 2024-519920-26-00: A pilot, open label, single dose, randomized, four-period, four-sequence, four-treatment crossover, comparative bioavailability study of UDCA PMCS 500 mg formulation 1 film-coated tablets (test 1 formulation), and UDCA PMCS 500 mg formulation 2 film-coated tablets (test 2 formulation), and UDCA PMCS 500 mg formulation 3 film-coated tablets (test 3 formulation), and reference formulation in healthy, male and female volunteers under fasting conditions.
Sponsor: Cepha s.r.o., PRO.MED.CS Praha a.s. (Pharmaceutical company). Phase: Human Pharmacology (Phase I)- Bioequivalence Study. Countries: Czechia (ended).
Therapeutic area(s): Diseases [C] - Digestive System Diseases [C06]
Gender: Female, Male. Age: 18-64 years. Enrolment: 24.
Status: Ended. Start date (EU): 2025-02-20. End date (EU): 2025-04-14. Decision date: 2025-02-12. Results received: No. Last updated: 2025-02-12.

Condition(s): UDCA causes a reduction in cholesterol saturation of the bile by inhibiting cholesterol absorption in the intestine and reducing cholesterol secretion into the bile. Presumably, cholesterol gallstones are gradually dissolved by dispersion of the cholesterol and formation of liquid crystals.

Source: https://euclinicaltrials.eu/ctis-public/view/2024-519920-26-00